EU clinical trial 2023-506981-30-00: (21839) A parallel-group treatment, Phase 2, double-blind, three-arm study to assess efficacy and safety of finerenone plus empagliflozin compared with either finerenone or empagliflozin in participants with chronic kidney disease and type 2 diabetes.
Protocol code: 21839
Sponsor: Bayer AG (Pharmaceutical company). Phase: Therapeutic exploratory (Phase II). Countries: Italy (ended), France (ended), Netherlands (ended), Belgium (ended), Spain (ended), Germany (ended), Denmark (ended).
Therapeutic area(s): Diseases [C] - Nutritional and Metabolic Diseases [C18]
Gender: Female, Male. Age: 18-64 years, 65+ years. Enrolment: 220.
Status: Ended. Start date (EU): 2022-05-25. End date (EU): 2025-02-26. End date: 2025-03-14. Decision date: 2024-05-07. Results received: Yes. Last updated: 2024-09-24.
Decision dates by country: NL: 2024-05-07, ES: 2024-05-10, IT: 2024-05-13, DE: 2024-05-10, FR: 2024-05-14, DK: 2024-05-08, BE: 2024-05-08

Condition(s): Chronic kidney disease in type 2 diabetes mellitus
Product: Kerendia 10 mg film coated tablets, Kerendia 20 mg film-coated tablets, Finerenone/Kerendia 10mg and 20mg Placebo equal to test product except active substance, Empagliflozin/Jardiance 10mg Placebo equal to test product except active substance, Jardiance 10 mg film-coated tablets

Primary endpoint: Mean ratio of change from baseline to Day 180 in Urinary albumin to creatinine ratio (UACR) for the combination therapy group, to empagliflozin alone., Mean ratio of change from baseline to Day 180 in UACR for the combination therapy group, to finerenone alone.
Endpoint(s): Relative change in UACR between end of treatment visit and 30 days after end of treatment visit., Relative change in UACR between 30 days after end of treatment visit and baseline., Relative change in UACR category (>30%, >40%, >50%) at 180 days., Ratio of change from baseline in eGFR at 30 days., eGFR decline greater than 30% at 30 days from baseline., Ratio of change in eGFR at 180 days and 210 days from day 30., Proportion of participants with of AKI events., Total number of AKI events., Number of participants with hyperkalemia events (moderate hyperkalemia [5.5 6.0 mmol/L]), Total number of hyperkalemia events (moderate hyperkalemia [5.5 6.0 mmol/L]), Change from baseline in K+, Proportion of participants with severe hypoglycemia events., Total number of events of severe hypoglycemia events., Proportion of participants with symptomatic hypotension events., Total number of symptomatic hypotension events., Proportion of participants with genital mycotic events., Total number of genital mycotic events., Proportion of participants with ketoacidosis events., Total number of ketoacidosis events., Proportion of participants with necrotizing fasciitis of the perineum events., Total number of necrotizing fasciitis of the perineum events., Proportion of participants with urosepsis and pyelonephritis events., Total number of urosepsis and pyelonephritis events.

Source: https://euclinicaltrials.eu/ctis-public/view/2023-506981-30-00